EU clinical trial 2024-517381-42-00: Safety of TEG001 in patients with r/r AML/high-risk MDS or r/r MM
Protocol code: NL58686.000.16
Sponsor: Universitair Medisch Centrum Utrecht (Hospital/Clinic/Other health care facility). Phase: Human Pharmacology (Phase I)- First administration to humans. Countries: Netherlands (ended).
Therapeutic area(s): Diseases [C] - Hemic and Lymphatic Diseases [C15]; Diseases [C] - Neoplasms [C04]
Gender: Female, Male. Age: 18-64 years, 65+ years. Enrolment: 18.
Status: Ended. Start date (EU): 2024-10-14. End date (EU): 2026-01-20. Decision date: 2024-10-14. Results received: No. Last updated: 2024-10-14.

Condition(s): Acute Myeloid Leukemia (AML), Myelodysplastic Syndrome (MDS), Multiple Myeloma (MM)

Source: https://euclinicaltrials.eu/ctis-public/view/2024-517381-42-00